EU clinical trial 2024-511340-29-02: Impact of peri-operative tEstosterone levels oN Functional and oncological Outcomes following RadiCal prostatEctomy (ENFORCE)
Sponsor: Canisius Wilhelmina Hospital (Hospital/Clinic/Other health care facility). Phase: Therapeutic confirmatory (Phase III). Countries: Netherlands (ended).
Therapeutic area(s): Diseases [C] - Hormonal diseases [C19]
Gender: Male. Age: 18-64 years, 65+ years. Enrolment: 140.
Status: Ended. Start date (EU): 2022-12-14. End date (EU): 2026-06-01. Decision date: 2024-12-11. Results received: No. Last updated: 2025-11-17.

Condition(s): Late-onset hypogonadism
Product: placebo gel, Androgel 16,2 mg/g, gel

Primary endpoint: The main endpoint for this study is the total sexual domain score coming from the EPIC-26 questionnaire, 12 months after radical prostatectomy. A change of 12 points in this domain is considered clinically relevant.
Endpoint(s): 1. EPIC-26 sexual functioning domain score [0-100] at 6 months after RP. A difference of 12 points or more is considered clinically relevant., 2. EPIC-26 sexual functioning domain score [0-100] at 24 months after RP. A difference of 12 points or more is considered clinically relevant., 3. EPIC-26 urinary incontinence domain score [0-100] at 12 months after RP. A difference of 9 points or more is considered clinically relevant., 4. EPIC-26 urinary incontinence domain score [0-100] at 24 months after RP. A difference of 9 points or more is considered clinically relevant., 5. EPIC-26 hormonal functioning domain score [0-100] at 12 months after RP. A difference of 6 points or more is considered clinically relevant., 6. EPIC-26 hormonal functioning domain score [0-100] at 24 months after RP. A difference of 6 points or more is considered clinically relevant., 7. Occurrence of biochemical recurrence (two times detectable PSA > 0.2 ng/ml), 8. In case of biochemical recurrence, time to recurrence in months.

Source: https://euclinicaltrials.eu/ctis-public/view/2024-511340-29-02